EU clinical trial 2024-513032-14-00: Master Protocol to Assess the Safety and Antitumor Activity of Genetically Engineered NY-ESO-1-Specific (c259) T Cells, alone or in combination with other agents, in HLA-A2+ Participants with NY-ESO-1 and/or LAGE-1a Positive Solid Tumors (IGNYTE-ESO)
Protocol code: 208467
Sponsor: USWM Ct LLC (Pharmaceutical company). Phase: Therapeutic exploratory (Phase II). Countries: Spain (ended), Netherlands (ended), France (ended), Italy (ended).
Therapeutic area(s): Diseases [C] - Neoplasms [C04]
Gender: Female, Male. Age: 0-17 years, 18-64 years, 65+ years. Enrolment: 21.
Status: Ended. Start date (EU): 2020-04-21. End date (EU): 2026-06-22. Decision date: 2024-06-17. Results received: No. Last updated: 2026-05-29.
Decision dates by country: FR: 2024-06-21, IT: 2024-06-26, NL: 2024-06-18, ES: 2024-06-17

Condition(s): Synovial sarcoma and Myxoid/Round Cell Liposarcoma (MRCLS)
Product: GSK3377794

Primary endpoint: Overall Response Rate (ORR) per RECIST v1.1
Endpoint(s): To evaluate efficacy of NY-ESO -1 ∙ Time to Response (TTR) ∙ Duration of Response (DoR) ∙ Disease Control Rate (DCR) ∙ Progression Free Survival (PFS), To evaluate safety and tolerability of NY-ESO-1 ∙ Frequency and severity of Adverse events (AEs), serious adverse events (SAEs) and AEs of special interest (AESI; as defined in protocol) ∙ Laboratory parameters ∙ Replication Competent Lentivirus (RCL) ∙ Instances of Insertional oncogenesis (IO)

Source: https://euclinicaltrials.eu/ctis-public/view/2024-513032-14-00